EU clinical trial 2025-524951-30-00: 161Tb-labeled Gastrin Analogue - A Novel Tool for Precision Treatment of Advanced Medullary Thyroid Cancer
Protocol code: MTC-Tb
Sponsor: Uniwersytet Jagiellonski Collegium Medicum (Educational Institution). Phase: Human Pharmacology (Phase I)- First administration to humans. Countries: Poland (not authorised).
Therapeutic area(s): Analytical, Diagnostic and Therapeutic Techniques and Equipment [E] - Diagnosis [E01]; Diseases [C] - Neoplasms [C04]
Gender: Female, Male. Age: 18-64 years, 65+ years. Enrolment: 30.
Status: Not authorised. Decision date: 2026-07-24. Results received: No. Last updated: 2026-07-24.

Condition(s): Thyroid cancer

Source: https://euclinicaltrials.eu/ctis-public/view/2025-524951-30-00